EU clinical trial 2023-510212-39-00: Alpha 2 adrenergic receptor agonists for the prevention of delirium and cognitive decline after open heart surgery (ALPHA2PREVENT): randomised controlled trial
Sponsor: Oslo University Hospital HF (Hospital/Clinic/Other health care facility). Phase: Phase III and phase IV (Integrated). Countries: Norway (ongoing, recruitment ended).
Therapeutic area(s): Psychiatry and Psychology [F] - Mental Disorders [F03]
Gender: Female, Male. Age: 65+ years. Enrolment: 900.
Status: Ongoing, recruitment ended. Start date (EU): 2024-09-10. Decision date: 2024-09-09. Results received: No. Last updated: 2026-04-13.

Condition(s): Delirium
Product: NaCl 9mg/ml, CLONIDINE, DEXMEDETOMIDINE

Primary endpoint: Cumulative incidence of postoperative delirium, as diagnosed according to Diagnostic and Statistical Manual of Mental Disorders, 5th edition (DSM-5) criteria
Endpoint(s): Incidence of coma or postoperative delirium, as measured by Richmond Agitation Sedation Scale (RASS) and according to DSM-5 criteria, Incidence of death, coma or postoperative delirium, as described above, Number of delirium days postoperatively, as diagnosed according to DSM-5 criteria, Delirium severity, as measured by Confusion Assessment Method for Intensive Care Units-7 (CAM-ICU)-7, Observational Scale of Level of Arousal (OSLA) and RASS, Motor activity patterns, assessed with body worn accelerometers, Change in cognitive function between inclusion and after 1 and 6 months, as graded by Montreal Cognitive Assessment (MoCA), 10-words memory task from The Consortium Establish a Registry for Alzheimer's Disease (CERAD), digit span tests, Trail making tests (TMT) A and B, semantic and phonemic verbal fluency, and measured repeatedly preoperatively and 1 and 6 months after surgery., Change in patient rated health status between inclusion and after 1 and 6 months, as assessed by the EQ-5D-5L questionnaire preoperatively and 1 and 6 months postoperatively, Comparison to inclusion of serum concentrations of neurofilament light (NFL) and p-tau181 1, 3 and 5 days postoperatively, Estimate associations between frailty and the other endpoints, as described above, Safety and tolerability as determined by the numbers of Adverse Events (AEs), serious AEs (SAEs) and suspected unexpected serious adverse reactions (SUSARs), and vital signs; blood pressure (BP), heart rate (HR), peripheral oxygen saturation (SpO2) postoperatively, Interaction between preoperative frailty and treatment on delirium and the other endpoints, as described above, Change in frailty status between inclusion and after 1 and 6 months, as graded by the frailty index (FI) and essential frailty toolset (EFT), and measured repeatedly preoperatively and 1 and 6 months after surgery, Comparison of change in frailty status between inclusion and after 1 and 6 months (as described above) between patients with or without postoperative delirium., Comparison of changes in EEG pattern from preoperatively to postoperatively in patients who do and do not develop delirium., Comparison of postoperative EEG in patients who do and do not develop delirium and the association with exposure to dexmedetomidine vs clonidine vs placebo, Additional biomarkers of neural injury, inflammation or neurotransmission may be explored, Sequential Organ Failure Assessment (SOFA) score

Source: https://euclinicaltrials.eu/ctis-public/view/2023-510212-39-00